EU clinical trial 2023-508740-21-00: An Open-label, Single-arm, Phase II, Multinational, Multicentre Study to Assess the Efficacy and Safety of 5 Years of Osimertinib in Participants withEpidermal Growth Factor Receptor Mutation-Positive Stage II-IIIB Non-small Cell Lung Carcinoma, Following Complete Tumour Resection With or Without Adjuvant Chemotherapy (TARGET)
Protocol code: D5162C00048
Sponsor: AstraZeneca AB (Pharmaceutical company). Phase: Therapeutic exploratory (Phase II). Countries: Spain (ongoing, recruitment ended), Italy (ongoing, recruitment ended).
Therapeutic area(s): Diseases [C] - Neoplasms [C04]
Gender: Female, Male. Age: 18-64 years, 65+ years. Enrolment: 125.
Status: Ongoing, recruitment ended. Start date (EU): 2023-02-15. Decision date: 2024-02-26. Results received: No. Last updated: 2025-08-27.
Decision dates by country: ES: 2024-02-26, IT: 2024-03-01

Condition(s): Non-Small Cell Lung Cancer
Product: TAGRISSO 80 mg film-coated tablets, TAGRISSO 40 mg film-coated tablets

Primary endpoint: DFS at 5 years per the investigator's assessment in the Common EGFRm Cohort
Endpoint(s): The measure of interest is the proportion of participants alive and disease-free at 3, 4, and 5 years, The measure of interest is the proportion of participants alive and disease-free at 3 and 4 years, The measure of interest is the proportion of participants alive at 3, 4, and 5 years

Source: https://euclinicaltrials.eu/ctis-public/view/2023-508740-21-00